EU clinical trial 2024-512940-51-00: Single-arm, multicenter Phase I/Ib study of avelumab + lenvatinib in children with primary CNS tumors
Protocol code: MS100070_0087
Sponsor: Merck Healthcare KGaA (Pharmaceutical company). Phase: Human Pharmacology (Phase I)- Other. Countries: France (ended), Germany (ended).
Therapeutic area(s): Diseases [C] - Neoplasms [C04]
Gender: Female, Male. Age: 0-17 years. Enrolment: 23.
Status: Ended. Start date (EU): 2021-11-24. End date (EU): 2026-05-28. End date: 2026-06-09. Decision date: 2024-06-26. Results received: Yes. Last updated: 2025-10-16.
Decision dates by country: FR: 2024-07-01, DE: 2024-06-26

Condition(s): Central Nervous System Tumors
Product: LENVIMA 10 mg hard capsules, LENVIMA 4 mg hard capsules, Bavencio 20 mg/mL concentrate for solution for infusion, LENVIMA 4 mg hard capsules, LENVIMA 10 mg hard capsules, LENVIMA 4 mg hard capsules, LENVIMA 10 mg hard capsules

Primary endpoint: Dose Escalation Part 1 Occurrence and severity of CTCAE Grade ≥ 3 TEAEs according to NCICTCAE Version 5.0., Dose Escalation Part 1 Occurrence of DLTs, Dose Expansion Part 2 PFS as assessed by Investigators according to RANO criteria
Endpoint(s): Dose Escalation Part 1 and Dose Expansion Part 2 Occurrence and severity of any grade TEAEs, treatment-related AEs, AESIs, deaths, and clinically significant changes in laboratory parameters., Dose Escalation Part 1 and Dose Expansion Part 2 Confirmed objective response as assessed by Investigators according to RANO criteria, Dose Escalation Part 1 PFS per RANO criteria and Overall Survival, Dose Expansion Part 2 Overall Survival, Dose Escalation Part 1 and Dose Expansion Part 2 PK parameters including CEOI, AUC, Ctrough of avelumab; Cmax, tmax, and AUC of lenvatinib of at least a single dose as data permit., Dose Escalation Part 1 and Dose Expansion Part 2 Immunogenicity of avelumab as measured by ADA assay

Source: https://euclinicaltrials.eu/ctis-public/view/2024-512940-51-00